EU clinical trial 2024-514082-19-00: A Phase 2, Multicenter, Randomized, Double-Blind, Placebo-Controlled Study Evaluating Safety and Efficacy of CORT113176 (Dazucorilant) in Patients with Amyotrophic Lateral Sclerosis (DAZALS)
Protocol code: CORT113176-652
Sponsor: Corcept Therapeutics Inc. (Pharmaceutical company). Phase: Therapeutic exploratory (Phase II). Countries: Netherlands (ongoing, recruiting), Germany (ongoing, recruiting), Belgium (ongoing, recruitment ended), Spain (ongoing, recruitment ended), Ireland (ongoing, recruitment ended), France (ongoing, recruitment ended), Poland (ongoing, recruitment ended).
Therapeutic area(s): Diseases [C] - Nervous System Diseases [C10]
Gender: Female, Male. Age: 18-64 years, 65+ years. Enrolment: 240.
Start date (EU): 2022-11-04. Decision date: 2024-10-14. Results received: No. Last updated: 2026-07-27.
Decision dates by country: ES: 2024-10-17, BE: 2024-10-14, IE: 2024-10-14, FR: 2024-10-17, DE: 2024-10-15, NL: 2024-10-14, PL: 2024-11-14

Condition(s): Amyotrophic Lateral Sclerosis
Product: Placebo to Dazucorilant softgel capsule, CORT113176, CORT113176

Primary endpoint: Part 1: Change from Baseline to Week 24 in the ALS Functional Rating Scale-Revised (ALSFRS-R) total score, Part 1: Incidence of AEs, SAEs, treatment-related AEs, AEs by severity, and death due to AEs, Part 2: Incidence of treatment-emergent AEs and SAEs, Part 2: Incidence of treatment-emergent AEs leading to dose interruptions, dose reductions, and/or discontinuations of study drug
Endpoint(s): Part 1: Change from Baseline to Week 24 in muscle strength (assessed using hand-held dynamometer), Part 1: Change from Baseline to Week 24 in: − Percent Slow Vital Capacity − EQ-5D-5L, Part 1: Time to death, Part 1: Time to respiratory support >22 hours per day for 7 days, Part 1: Time to death or time to respiratory support >22 hours per day for 7 days, Part 1: Combined Assessment of Function and Survival (CAFS), Part 1: Plasma samples for pharmacokinetic (PK) analysis will be obtained in a dedicated PK substudy in a subset (~20%) of patients at the Week 3 visit. The dazucorilant AUC and Cmax will be reported.

Source: https://euclinicaltrials.eu/ctis-public/view/2024-514082-19-00